EU clinical trial 2025-521362-10-00: Assessing the Efficacy of a Single Measurement and Adjustment Strategy for DOACs in Frail Older Patients: Insights from the DOAC-FRAIL RCT. A step towards safe(r) DOAC utilization in the frail older population.
Sponsor: Academisch Ziekenhuis Maastricht (Hospital/Clinic/Other health care facility). Phase: Phase III and phase IV (Integrated). Countries: Netherlands (ongoing, recruiting).
Therapeutic area(s): Diseases [C] - Cardiovascular Diseases [C14]
Gender: Female, Male. Age: 65+ years. Enrolment: 2000.
Status: Ongoing, recruiting. Start date (EU): 2026-01-06. Decision date: 2025-07-28. Results received: No. Last updated: 2025-12-22.

Condition(s): Frail older patients with atrial fibrillation or venous thromboembolism
Product: DABIGATRAN ETEXILATE, APIXABAN, RIVAROXABAN, EDOXABAN

Primary endpoint: Our primary end point is the composite outcome of thromboembolic events or bleedings. Bleeding is defined as major bleeding or a clinically relevant non-major (CRNM) bleeding, based on the definition of the International Society on Thrombosis and Haemostasis (ISTH). Thromboembolic events include ischemic stroke, transient ischemic accident (TIA) en peripheral thromboembolism.
Endpoint(s): Our secondary end points are (1) the prevalence of deviant DOAC levels in the frail older population, (2) determinants are associated with a deviant DOAC level, (3) differences in quality of life between both groups, (4) the feasibility/acceptability of the Single Measurement and adjustment strategy via a qualitative study, (5) cost-effectiveness of the intervention, and (6) mortality.

Source: https://euclinicaltrials.eu/ctis-public/view/2025-521362-10-00